EU clinical trial 2024-519792-25-00: Elacestrant and exemestane for patients with pretreated HR+/HER2- metastatic breast cancer and [18F]-FES-avid lesions (COMBINE): a proof-of-concept phase 2 clinical trial
Protocol code: UID 4270
Sponsor: Istituto Europeo Di Oncologia S.r.l. (Hospital/Clinic/Other health care facility). Phase: Therapeutic exploratory (Phase II). Countries: Italy (ongoing, recruiting).
Therapeutic area(s): Diseases [C] - Neoplasms [C04]
Gender: Female, Male. Age: 18-64 years, 65+ years. Enrolment: 26.
Status: Ongoing, recruiting. Start date (EU): 2026-05-11. Decision date: 2025-10-10. Results received: No. Last updated: 2025-10-10.

Condition(s): Metastatic hormone receptor-positive/HER2-negative breast cancer
Product: EstroTep 500 MBq/mL, solution injectable, ELACESTRANT, EXEMESTANE, ELACESTRANT

Primary endpoint: 6-month PFS rate per RECIST v 1.1
Endpoint(s): Adverse Events per CTCAE 5.0, Median Overall Survival, Overall Response Rate per RECIST 1.1, Median QoL change from baseline to week 8 of treatment measured by EORTC QLQ-C30 and FACT-ES v.4 questionaries, 6-months Progression-free survival (PFS) rate per RECIST 1.1 according to baseline FES-SUV and SUV variation of FES

Source: https://euclinicaltrials.eu/ctis-public/view/2024-519792-25-00